EU clinical trial 2022-502065-23-00: A Randomized, Open-label, Phase 2 study of Botensilimab (AGEN1181) as Monotherapy and in Combination with Balstilimab (AGEN2034) or Investigator’s Choice Standard of Care (Regorafenib or Trifluridine and Tipiracil) for the Treatment of Refractory Metastatic Colorectal Cancer
Protocol code: C-800-25
Sponsor: Agenus Inc. (Pharmaceutical company). Phase: Therapeutic exploratory (Phase II). Countries: Italy (ongoing, recruitment ended), France (ongoing, recruitment ended), Belgium (ongoing, recruitment ended), Spain (ongoing, recruitment ended).
Therapeutic area(s): Diseases [C] - Neoplasms [C04]
Gender: Female, Male. Age: 18-64 years, 65+ years. Enrolment: 102.
Status: Ongoing, recruitment ended. Start date (EU): 2023-06-01. Decision date: 2023-03-06. Results received: No. Last updated: 2026-03-25.
Decision dates by country: BE: 2023-03-06, FR: 2023-03-10, IT: 2023-03-13, ES: 2023-03-15

Condition(s): Refractory Metastatic Colorectal Cancer
Product: Lonsurf 15 mg/6.14 mg film-coated tablets, Lonsurf 20 mg/8.19 mg film-coated tablets, Stivarga 40 mg film-coated tablets, BOTENSILIMAB, Lonsurf 15 mg/6.14 mg film-coated tablets, BALSTILIMAB, Lonsurf 20 mg/8.19 mg film-coated tablets, Stivarga 40 mg film-coated tablets., Lonsurf 20 mg/8.19 mg film-coated tablets, Lonsurf 15 mg/6.14 mg film-coated tablets

Primary endpoint: ORR, defined as the proportion of patients with a complete response or partial response as assessed by RECIST 1.1 criteria.
Endpoint(s): 01. DOR, defined as the time from initial objective radiographic response until disease progression or death, whichever occurs first., 02. PFS, defined as the time from randomization until disease progression or death, whichever occurs first., 03. OS, defined as the time from randomization until death due to any cause.

Source: https://euclinicaltrials.eu/ctis-public/view/2022-502065-23-00